EU clinical trial 2022-501090-39-00: An Open-label Extension Study to Evaluate Long-term Efficacy and Safety of Odevixibat (A4250) in Children with Biliary Atresia (BOLD-EXT)
Protocol code: A4250-016
Sponsor: Ipsen Pharma (Pharmaceutical company). Phase: Therapeutic confirmatory (Phase III). Countries: Spain (ongoing, recruiting), Italy (ongoing, recruiting), Germany (ongoing, recruiting), Poland (ongoing, recruiting), Hungary (ongoing, recruiting), France (ongoing, recruiting), Netherlands (ongoing, recruiting), Belgium (ended).
Therapeutic area(s): Diseases [C] - Congenital, Hereditary, and Neonatal Diseases and Abnormalities [C16]
Gender: Female, Male. Age: 0-17 years. Enrolment: 57.
Start date (EU): 2022-12-14. Decision date: 2022-10-20. Results received: No. Last updated: 2026-07-30.
Decision dates by country: HU: 2023-01-27, BE: 2023-01-16, NL: 2023-01-11, ES: 2022-10-20, IT: 2022-10-21, DE: 2022-10-20, PL: 2022-11-22, FR: 2023-02-02

Condition(s): Biliary Atresia
Product: A4250, A4250, A4250, A4250

Primary endpoint: Time from the date of first dose of study treatment to first occurrence of liver transplant, or death
Endpoint(s): • Change in aspartate aminotransferase (AST) to platelet ratio index (APRI) score from baseline to Weeks 4, 13, 26, 39, 52, 78, and 104 • Change in fibrosis-4 (Fib-4) score from baseline to Weeks 4, 13, 26, 39, 52, 78 and 104 • Change from baseline in serum bile acids at Weeks 26, 52, 78, and 104, • Change in growth from baseline to Weeks 26, 52, 78, and 104 after initiation of odevixibat treatment, defined as the linear growth deficit (height for age, weight for age, and body mass index [BMI]) compared to a standard growth curve (Z-score, standard deviation [SD] from P50); mid-arm circumference, • Time to onset of first sentinel event during the 104-week treatment period., • Change in pediatric end-stage liver disease (PELD) score from baseline to Weeks 26, 52, 78, and 104, • Proportion of patients who are alive and have not undergone a liver transplant at Weeks 26, 52, 78 and 104

Source: https://euclinicaltrials.eu/ctis-public/view/2022-501090-39-00